EU clinical trial 2022-502600-79-00: INCMGA 0012-204: An Umbrella Study of INCMGA00012 Alone and in Combination With Other Therapies in Participants With Advanced or Metastatic Endometrial Cancer Who Have Progressed on or After Platinum-Based Chemotherapy (POD1UM-204)
Protocol code: INCMGA0012-204
Sponsor: Incyte Corp. (Pharmaceutical company). Phase: Therapeutic exploratory (Phase II). Countries: Belgium (ended), Italy (ended), France (ended), Greece (ended).
Therapeutic area(s): Diseases [C] - Neoplasms [C04]
Gender: Female. Age: 18-64 years, 65+ years. Enrolment: 88.
Status: Ended. Start date (EU): 2021-03-16. End date (EU): 2026-05-29. End date: 2026-05-29. Decision date: 2023-11-27. Results received: No. Last updated: 2026-06-05.
Decision dates by country: GR: 2024-01-22, BE: 2023-11-28, IT: 2023-11-29, FR: 2023-11-27

Condition(s): Endometrial cancer, Endometrial cancer
Product: INCAGN02390, Pemazyre 4.5 mg tablets, Retifanlimab (INCMGA00012), INCAGN02385

Primary endpoint: Group A (INCMGA00012 monotherapy): ORR, defined as the proportion of participants having a CR or PR according to RECIST v1.1, will be determined by ICR.
Endpoint(s): Group A and B (INCMGA00012 monotherapy): DOR, defined as the time from the first documented objective response (CR or PR) according to RECIST v1.1 (as determined by ICR) until disease progression or death due to any cause, Group A and B (INCMGA00012 monotherapy): DCR, defined as the proportion of participants with CR, PR, or SD (as determined by ICR) as best response., Group A and B (INCMGA00012 monotherapy): PFS, defined as the time from the first dose of study treatment until disease progression (as determined by ICR) or death due to any cause., Group A and B (INCMGA00012 monotherapy): OS, defined as the time from the first dose of study treatment until death due to any cause., All other groups: • ORR, defined as the proportion of participants having a CR or PR according to RECIST v1.1 (as determined by the investigator). Safety and tolerability will be assessed by monitoring the frequency and severity of AEs and SAEs as well as laboratory test results.

Source: https://euclinicaltrials.eu/ctis-public/view/2022-502600-79-00